EU clinical trial 2023-509518-12-01: An Open label, Safety Clinical trial of (+)-α-dihydrotetrabenazine in patients with moderate to severe tardive dyskinesia
Protocol code: ADT-2023-001
Sponsor: Adeptio Pharmaceuticals Limited (Pharmaceutical company). Phase: Therapeutic exploratory (Phase II). Countries: Czechia (ongoing, recruiting), Poland (authorised, recruitment pending).
Therapeutic area(s): Diseases [C] - Nervous System Diseases [C10]
Gender: Female, Male. Age: 18-64 years, 65+ years. Enrolment: 70.
Start date (EU): 2024-04-16. Decision date: 2024-04-03. Results received: No. Last updated: 2026-04-24.
Decision dates by country: PL: 2025-04-27, CZ: 2024-04-08

Condition(s): Tardive dyskinesia
Product: (+)-α-DIHYDROTETRABENAZINE

Primary endpoint: Change in Abnormal Involuntary Movement Scale (AIMS) score (items 1 through 7) from Baseline of this study to the end of long-term therapy (Week 54), as assessed by the blinded central video rating.
Endpoint(s): Incidence of AEs, SAEs, drug-related AEs, severe AEs, AEs leading to discontinuation during the following periods: 1. Overall 2. Titration period 3. Long-term treatment, Observed values and changes in clinical laboratory parameters (haematology, chemistry including prolactin, and urinalysis), Observed values and changes in vital signs, Observed values and changes in ECG parameters and abnormal findings, Observed values and changes in HADS and, C-SSRS., The proportion of subjects who have a treatment success at the end of long-term therapy (Week 54) based on a Clinical Global Impression of Change (CGIC). A treatment success is defined as Much or Very Much Improved on the CGIC at the end of long-term therapy (Week 54)., The proportion of subjects who have ≥3-point reduction in AIMS score from Baseline of this study to the end of long-term therapy (Week 54)., The percent change in AIMS score from Baseline of this study to the end of long-term therapy (Week 54)., The proportion of subjects who have a treatment success at the end of long-term therapy (Week 54) based on a Patient Global Impression of Change (PGIC). A treatment success is defined as Much or Very Much Improved on the PGIC at the end of long-term therapy (Week 54).

Source: https://euclinicaltrials.eu/ctis-public/view/2023-509518-12-01